EU clinical trial 2025-521126-15-00: Safety and efficacy of treatment combination with ponatinib and asciminib in chronic myeloid leukemia patients resistant to ponatinib and/or asciminib
Protocol code: PONTHIAC
Sponsor: Grupo Espanol De Leucemia Mieloide Cronica (GELMC) (Patient organisation/association). Phase: Therapeutic exploratory (Phase II). Countries: Spain (authorised, recruiting).
Therapeutic area(s): Diseases [C] - Neoplasms [C04]
Gender: Female, Male. Age: 18-64 years, 65+ years. Enrolment: 30.
Status: Authorised, recruiting. Start date (EU): 2026-07-09. Decision date: 2026-06-01. Results received: No. Last updated: 2026-06-01.

Condition(s): Chronic Myeloid Leukemia
Product: Scemblix 40 mg film-coated tablets, Scemblix 20 mg film-coated tablets, Iclusig 45 mg film-coated tablets

Primary endpoint: MR2 is defined as ≤ 1% BCR::ABL1 at 6 months.
Endpoint(s): Cmax and Tmax will be determinate., A complete cytogenetic response (CCyR) is defined as absence of the Ph among at least 20 cells in meta phase in a bone marrow aspirate at 6 months., Type, frequency, and severity of adverse events., A complete cytogenetic response (CCyR) is defined as absence of the Ph among at least 20 cells in metaphase in a bone marrow aspirate at 12 months., MR2, MR3/MMR, MR4, and MR4.5 at 3-month intervals and MR1 (≤ 10% BCR::ABL1) at 3 months., Complete hematologic response (CHR) at 3 months., Number of patients who discontinue permanently treatment with asciminib and/or ponatinib due to AEs., Number of patients who interrupt the dose of treatment and dose reductions with asciminib and ponatinib due to AEs., Duration of response is defined as the time between date of the first efficacy evaluation that the subject has met all criteria for BRC::ABL<1% and progression., TTR is defined as the time between date of first dose of combination and the first efficacy evaluation that the subject has met all criteria for BRC::ABL<1%., Number of patients who progress to accelerated phase (AP-) or blast phase (BP-) CML., PFS is defined as the time from the date of first dose of combination to the date of first documented disease progression., EFS is defined as the time from the date of first dose of combination to the date of first documentation of an event (disease progression or death) or permanent discontinuation of asciminib or ponatinib., OS is defined as the time from the date of first dose of combination to the date of death (any cause).

Source: https://euclinicaltrials.eu/ctis-public/view/2025-521126-15-00